EU clinical trial 2024-515060-32-00: A Randomized, Double-Blind, Placebo-Controlled Multicenter Study of Levosimendan Therapy in low ejection fraction Takotsubo Syndrome (LevoTako Trial)
Protocol code: NBK182/1/2022
Sponsor: Medical University Of Gdansk (Educational Institution). Phase: Therapeutic confirmatory (Phase III). Countries: Poland (ended).
Therapeutic area(s): Diseases [C] - Cardiovascular Diseases [C14]
Gender: Female, Male. Age: 18-64 years, 65+ years. Enrolment: 190.
Status: Ended. Start date (EU): 2024-11-22. End date (EU): 2025-12-22. Decision date: 2024-12-16. Results received: No. Last updated: 2025-12-14.

Condition(s): Takotsubo syndrome
Product: Simdax, 2,5 mg/mL, koncentrat do sporządzania roztworu do infuzji, GLUCOSUM 5% FRESENIUS, 50 mg/ml, roztwór do infuzji

Primary endpoint: In-hospital LVEF recovery
Endpoint(s): Composite endpoint including 12-month all-cause mortality or major adverse cardiovascular events rate (rehospitalization due to TTS recurrence or heart failure, stroke or TIA, whatever occurs first)

Source: https://euclinicaltrials.eu/ctis-public/view/2024-515060-32-00